EU clinical trial 2024-517211-79-00: PTX3 genetically stratified randomized double-blinded allocation event-driven clinical trial for antifungal prophylaxis in patients with acute myeloid leukemia
Protocol code: PTX3-AML
Sponsor: Centre Hospitalier Universitaire Vaudois (Hospital/Clinic/Other health care facility). Phase: Therapeutic use (Phase IV). Countries: Belgium (ongoing, recruiting), France (ongoing, recruiting).
Therapeutic area(s): Diseases [C] - Bacterial Infections and Mycoses [C01]
Gender: Female, Male. Age: 18-64 years, 65+ years. Enrolment: 102.
Status: Ongoing, recruiting. Start date (EU): 2024-10-16. Decision date: 2024-10-16. Results received: No. Last updated: 2026-07-29.
Decision dates by country: BE: 2024-10-16, FR: 2024-10-17

Condition(s): Antifungal prophylaxis in patients with acute myeloid leukemia
Product: Diflucan 2 mg/ml Infusionslösung, FLUCONAZOLE KABI 2 mg/ml, solution pour perfusion., FLUCONAZOLE ARROW 200 mg, gélule, Noxafil 40 mg/mL oral suspension, FLUCONAZOLE ARROW 50 mg, gélule, POSACONAZOLE ZENTIVA 100 mg, comprimé gastro-résistant, POSACONAZOLE VIATRIS 40 mg/mL, suspension buvable, Diflucan 50 mg Hartkapseln, Noxafil 40 mg/mL oral suspension

Primary endpoint: The cumulative incidence of proven and probable IMI in the intention-to-treat (ITT) population by day 180 (within 180 days from the first dose of antifungal prophylaxis treatment after randomization)
Endpoint(s): The cumulative incidence of possible IMI by day 180 in the ITT population., The cumulative incidence of probable and proven IFI, namely: (a) all IFI, (b) IA only and (c) IC only in the ITT patient population by day 180, The time to probable and proven IMI during 180 days in the ITT population., The cumulative incidence of mortality at day 180, The time to first use and the number of patient-days of amphotericin B or an echinocandin in the ITT population during 180 days., The frequency and distribution of adverse events (AE) of interest in posaconazole and fluconazole treated participants in the ITT population during 180 days, namely (a) elevation of liver tests and (b) prolongation of QTc interval on ECG., Treatment success vs. failure. Treatment failure was defined as any of the following: proven or probable IFI, administration of any other systemically administered antifungal treatment for more than 10 consecutive days, discontinuation of prophylaxis for any other reason (e.g. severe adverse event associated with the study medication), death, loss to follow-up, or withdrawal from the study, The cumulative incidence of probable and proven IFI, namely: all IFI, all IMI, IA only and IC only in the per protocol (PP) population by day 180.

Source: https://euclinicaltrials.eu/ctis-public/view/2024-517211-79-00